EU clinical trial 2025-520854-12-00: Use of tacrolimus and MTOR inhibitors with anticipatory therapy vs. tacrolimus and mycophenolic acid with universal prophylaxis in renal recipients at high risk of post-transplant cytomegalovirus. Phase IV clinical trial (TIMTOR STUDY).
Protocol code: TIMTOR
Sponsor: Hospital Universitario La Paz (Hospital/Clinic/Other health care facility). Phase: Therapeutic use (Phase IV). Countries: Spain (ongoing, recruiting).
Therapeutic area(s): Diseases [C] - Pathological Conditions, Signs and Symptoms [C23]
Gender: Female, Male. Age: 18-64 years, 65+ years. Enrolment: 30.
Status: Ongoing, recruiting. Start date (EU): 2026-01-15. Decision date: 2025-06-16. Results received: No. Last updated: 2026-01-20.

Condition(s): advanced chronic renal insufficiency
Product: Valganciclovir Aurovitas 450 mg comprimidos recubiertos con película EFG, Urbason 40 mg polvo y disolvente para solución inyectable, prednisona cinfa 5 mg comprimidos EFG, Myfortic 180 mg comprimidos gastrorresistentes., Advagraf 1 mg prolonged-release hard capsules, Rapamune 0.5 mg coated tablets, TIMOGLOBULINA 5 mg/ml, polvo para solución para perfusión

Primary endpoint: Presence of CMV infection or disease after renal transplantation. This variable will be evaluated at 6 months post-transplantation.
Endpoint(s): Recipient demographic variables: gender and age, Recipient variables related to chronic kidney disease (CKD): etiology of CKD, renal replacement therapy (RRT) prior to transplantation, time on RRT in months., Donor variables: demographics (age and sex), cause of death, donor type (living, cadaveric and cadaveric donor type), Ig G CMV serology., Peri-transplant variables, CMV-related variables

Source: https://euclinicaltrials.eu/ctis-public/view/2025-520854-12-00